EU clinical trial 2022-502668-20-00: (20290) A Phase 1/2 Study of the Oral TRK Inhibitor Larotrectinib in Pediatric Patients with Advanced Solid or Primary Central Nervous System Tumors
Protocol code: 20290
Sponsor: Bayer Consumer Care AG, Bayer AG (Pharmaceutical company). Phase: Phase I and Phase II (Integrated)- Other. Countries: France (ended), Netherlands (ended), Czechia (ended), Italy (ended), Germany (ended), Sweden (ended), Spain (ended), Ireland (ended), Denmark (ended).
Therapeutic area(s): Diseases [C] - Neoplasms [C04]
Gender: Female, Male. Age: 0-17 years, 18-64 years. Enrolment: 73.
Status: Ended. Start date (EU): 2017-04-11. End date (EU): 2026-06-08. Decision date: 2023-11-30. Results received: No. Last updated: 2026-04-09.
Decision dates by country: IE: 2023-11-30, DK: 2023-11-30, DE: 2023-12-05, IT: 2023-12-01, CZ: 2023-11-30, FR: 2023-11-30, NL: 2023-11-30, SE: 2023-12-01, ES: 2023-11-30

Condition(s): Solid tumors harboring NTRK fusion
Product: Larotrectinib Bayer, Larotrectinib Bayer, Larotrectinib Bayer

Primary endpoint: Phase 1: Number of subjects in an assigned dose cohort with treatment emergent adverse events (TEAEs) by grade assessed by National Cancer Institute-Common Terminology Criteria for Adverse Events (NCI-CTCAE) v 4.03 who experience a Dose-limiting toxicity (DLT)., Phase 1: Number of participants with TEAEs, Phase 1: Severity of TEAEs, Phase 2: Overall response rate (ORR) by IRRC
Endpoint(s): Phase 1: Maximum concentration of larotrectinib in plasma (Cmax), Phase 1: Area under the concentration versus time curve from time 0 to t (AUC0–t) of larotrectinib in plasma, Phase 1: Oral clearance (CL/F), Phase 1: Cerebral spinal fluid/plasma ratio of larotrectinib, Phase 1: Maximum tolerated dose (MTD), Phase 1: Recommended dose for Phase 2, Phase 1: Overall Response Rate (ORR), Phase 1: Mean change from baseline in Pain scores as assessed by the Wong-Baker Faces scale, Phase 1: Mean change in Health-related quality of life scores by Pediatrics Quality of Life - Core Module (PedsQL-Core), Phase 2: Best overall response (BOR), Phase 2: Duration of response (DOR), Phase 2: Proportion of patients with any tumor regression (i.e., any decrease from baseline of the longest diameters of target lesions) as a best response, Phase 2: Progression-free survival (PFS), Phase 2: Overall survival (OS), Phase 2: Number of participants with Treatment emergent adverse events (TEAEs), Severity of adverse events as assessed by NCI-CTCAE grading V 4.03, Phase 2: Clinical Benefit Rate (CBR), Phase 2: Concordance coefficient, Phase 2: Post-operative tumor staging, Phase 2: Post-operative surgical margin assessment, Phase 2: Pre-treatment surgical plan to preserve function and cosmetic outcome, Phase 2: Post-treatment plans to conserve function and cosmetic outcome

Source: https://euclinicaltrials.eu/ctis-public/view/2022-502668-20-00